EU clinical trial 2023-505425-14-00: An open-label, multicenter, phase 1b/2 study of E7386 in combination with pembrolizumab in previously treated subjects with selected solid tumors
Protocol code: E7386-G000-201
Sponsor: Eisai Limited (Pharmaceutical company). Phase: Phase I and Phase II (Integrated)- Other. Countries: Spain (ended).
Therapeutic area(s): Diseases [C] - Neoplasms [C04]
Gender: Female, Male. Age: 18-64 years, 65+ years. Enrolment: 30.
Status: Ended. Start date (EU): 2022-08-11. End date (EU): 2024-10-15. End date: 2024-10-16. Decision date: 2024-02-19. Results received: Yes. Last updated: 2024-09-30.
Decision dates by country: ES: 2024-05-13

Condition(s): colorectal cancer, melanoma, hepatocellular carcinoma
Product: LENVIMA 4 mg hard capsules, E7386, KEYTRUDA 25 mg/mL concentrate for solution for infusion, E7386, LENVIMA 10 mg hard capsules

Primary endpoint: Phase 1b part: Safety related endpoints including DLT, Phase 2 part: ORR is defined as the proportion of subjects who have best overall response (BOR) of confirmed CR or PR per RECIST 1.1
Endpoint(s): BOR per RECIST 1.1 (for Phase 1b part)., DOR is defined as the time from the first documentation of CR or PR to the first documentation of disease progression or death due to any cause (whichever occurs first), in subjects with confirmed CR or PR per RECIST 1.1, DCR is defined as the proportion of subjects who have a BOR of confirmed CR or PR, or SD: after ≥5 weeks from the first dose) per RECIST 1.1, CBR is defined as the proportion of subjects who have a BOR of confirmed CR or PR, or durable SD (duration of SD ≥23 weeks) per RECIST 1.1, Safety and tolerability (eg, treatment-emergent adverse events, treatment-related adverse events) for E7386 in combination with pembrolizumab and safety and tolerability including DLTs for E7386 in combination with pembrolizumab plus lenvatinib, PK profile of E7386 when co-administered either with pembrolizumab (doublet treatment cohorts) or with pembrolizumab plus lenvatinib (triplet treatment cohorts), PK profile of lenvatinib in combination with E7386 and pembrolizumab (triplet treatment cohorts)

Source: https://euclinicaltrials.eu/ctis-public/view/2023-505425-14-00